EU clinical trial 2024-512192-12-00: Corticosteroid in treatment of acute laryngitis among vocal professionals
Sponsor: HUS-Yhtymae (Hospital/Clinic/Other health care facility). Phase: Phase III and phase IV (Integrated). Countries: Finland (authorised, recruitment pending).
Therapeutic area(s): Diseases [C] - Otorhinolaryngologic Diseases [C09]
Gender: Female, Male. Age: 18-64 years. Enrolment: 70.
Status: Authorised, recruitment pending. Decision date: 2024-10-29. Results received: No. Last updated: 2024-10-29.

Condition(s): Acute laryngitis
Product: White, flat round, uncoated tablet. Diameter 9 mm., Prednisolon 20 mg tabletit

Primary endpoint: The duration of the vocal symptoms
Endpoint(s): Inflammatory findings of larynx (especially in vocal cords) in laryngoscopy

Source: https://euclinicaltrials.eu/ctis-public/view/2024-512192-12-00